EU clinical trial 2024-519296-25-00: A study investigating the safety, absorption, and elimination of RO7795068, a new compound that may potentially be used in the treatment of obesity
Protocol code: BP45801
Sponsor: F. Hoffmann-La Roche AG (Pharmaceutical company). Phase: Human Pharmacology (Phase I)- Other. Countries: Netherlands (ended).
Therapeutic area(s): Phenomena and Processes [G] - Metabolism [G03]
Gender: Female, Male. Age: 18-64 years. Enrolment: 100.
Status: Ended. Start date (EU): 2025-03-11. End date (EU): 2026-06-11. Decision date: 2025-02-19. Results received: No. Last updated: 2026-04-13.
Decision dates by country: NL: 2025-03-06

Condition(s): Healthy volunteers

Source: https://euclinicaltrials.eu/ctis-public/view/2024-519296-25-00